EU clinical trial 2023-506145-38-00: A Phase 1, Open-Label, Safety and Tolerability Study of INCB057643 in Participants With Myelofibrosis and Other Advanced Myeloid Neoplasms
Protocol code: INCB 57643-103
Sponsor: Incyte Corp. (Pharmaceutical company). Phase: Human Pharmacology (Phase I)- Other. Countries: Italy (ongoing, recruitment ended), Spain (ongoing, recruitment ended), Finland (ended).
Therapeutic area(s): Diseases [C] - Neoplasms [C04]
Gender: Female, Male. Age: 18-64 years, 65+ years. Enrolment: 44.
Start date (EU): 2021-05-11. Decision date: 2023-12-05. Results received: No. Last updated: 2026-07-01.
Decision dates by country: FI: 2023-12-11, ES: 2023-12-05, IT: 2023-12-06

Condition(s): Treatment of participants with MF, MDS, ET, or MDS/MPN

Source: https://euclinicaltrials.eu/ctis-public/view/2023-506145-38-00